EU clinical trial 2023-508066-15-01: 18F-FDG versus 68Ga-FAPI-46 as PET tracer in ER-positive breast cancer - a pilot study
Sponsor: University Hospital Maastricht (Hospital/Clinic/Other health care facility). Phase: Therapeutic exploratory (Phase II). Countries: Netherlands (ongoing, recruiting).
Therapeutic area(s): Diseases [C] - Neoplasms [C04]; Analytical, Diagnostic and Therapeutic Techniques and Equipment [E] - Diagnosis [E01]
Gender: Female. Age: 18-64 years, 65+ years. Enrolment: 20.
Status: Ongoing, recruiting. Start date (EU): 2025-09-01. Decision date: 2025-03-18. Results received: No. Last updated: 2026-06-05.

Condition(s): Hormone-positive breast cancer
Product: 68Ga-FAPI-46, Steripet 250 MBq/ml Oplossing voor injectie

Primary endpoint: The proportion of discordant pairs: How many lesions are detected on the 68Ga-FAPI-46 PET scan but not on the 18F-FDG PET scan and how many lesions are detected on the 18F-FDG PET scan but not on the 68Ga-FAPI-46 PET scan?
Endpoint(s): To investigate the proportion of 68Ga-FAPI-46-positive 18F-FDG-negative lesions for which performing a biopsy is not feasible.

Source: https://euclinicaltrials.eu/ctis-public/view/2023-508066-15-01